EU clinical trial 2024-518601-17-00: Phase III Randomized, Double-Blind Clinical Trial to Determine the Role of Magnesium Sulfate in Adductor Canal Block in Total Knee Arthroplasty
Protocol code: FPS-SMG-2021-02
Sponsor: Fundacion Progreso Y Salud (Patient organisation/association). Phase: Therapeutic confirmatory (Phase III). Countries: Spain (authorised, recruitment pending).
Therapeutic area(s): Analytical, Diagnostic and Therapeutic Techniques and Equipment [E] - Anesthesia and Analgesia [E03]
Gender: Female, Male. Age: 18-64 years, 65+ years. Enrolment: 131.
Status: Authorised, recruitment pending. Decision date: 2024-10-14. Results received: No. Last updated: 2024-10-14.

Condition(s): Total knee arthroplasty
Product: MAGNESIUM SULFATE, ROPIVACAINE HYDROCHLORIDE, SALINE

Primary endpoint: Time in minutes elapsed from when the patient receives the adductor canal block until the first request for rescue analgesia.

Source: https://euclinicaltrials.eu/ctis-public/view/2024-518601-17-00